EU clinical trial 2024-511169-12-00: A Phase III, Randomised, Open-Label Study of Savolitinib in Combination With Osimertinib Versus Platinum-Based Doublet Chemotherapy in Participants With EGFR Mutated MET-Overexpressed and/or Amplified, Locally Advanced or Metastatic Non-Small Cell Lung Cancer Who Have Progressed on Treatment With Osimertinib (SAFFRON)
Protocol code: D5087C00001
Sponsor: AstraZeneca AB (Pharmaceutical company). Phase: Therapeutic confirmatory (Phase III). Countries: Germany (ongoing, recruitment ended), Poland (ongoing, recruitment ended), Spain (ongoing, recruitment ended), France (ongoing, recruitment ended), Austria (ongoing, recruitment ended), Belgium (ongoing, recruitment ended), Bulgaria (ongoing, recruitment ended), Greece (ongoing, recruitment ended), Italy (ongoing, recruitment ended).
Therapeutic area(s): Diseases [C] - Neoplasms [C04]
Gender: Female, Male. Age: 18-64 years, 65+ years. Enrolment: 87.
Status: Ongoing, recruitment ended. Start date (EU): 2023-03-28. Decision date: 2024-07-26. Results received: No. Last updated: 2026-07-16.
Decision dates by country: BE: 2024-07-26, ES: 2024-07-29, BG: 2024-08-14, DE: 2024-07-31, AT: 2024-07-31, FR: 2024-07-30, GR: 2024-07-29, PL: 2024-08-04, IT: 2024-08-05

Condition(s): Non-Small Cell Lung Cancer
Product: TAGRISSO 40 mg film-coated tablets, Cisplatine Teva 1 mg/ml concentraat voor oplossing voor infusie., Carboplatin 10 mg/ml concentrate for solution for infusion, Cisplatin Teva® 1 mg/ml Konzentrat zur Herstellung einer Infusionslösung, CARBO-cell® 10 mg/ml Infusionslösung, Konzentrat zur Herstellung einer Infusionslösung, Pemetrexed Accord 25 mg/ml concentrate for solution for infusion, ALIMTA 500 mg powder for concentrate for solution for infusion, Pemetrexed Accord 25 mg/ml concentrate for solution for infusion, Cisplatine Teva 1 mg/ml concentraat voor oplossing voor infusie., Pemetrexed Accord 25 mg/ml concentrate for solution for infusion, Savolitinib, ALIMTA 100 mg powder for concentrate for solution for infusion, TAGRISSO 80 mg film-coated tablets, Cisplatine Teva 1 mg/ml concentraat voor oplossing voor infusie., Pemetrexed Accord 25 mg/ml concentrate for solution for infusion, Carboplatin Kabi 10 mg/ml Konzentrat zur Herstellung einer Infusionslösung

Primary endpoint: PFS as defined as time from randomisation until progression per RECIST 1.1 as assessed by BICR, or death due to any cause in participants with centrally confirmed MET IHC+ and/or MET FISH+ status (FAS). The comparison will include all randomised participants, as randomised, regardless of whether the participant withdraws from randomised therapy, receives another anti-cancer therapy, or clinically progresses prior to RECIST 1.1 progression.
Endpoint(s): Overall survival defined as time from randomisation until the date of death due to any cause., Progression-free survival defined as time from randomisation until progression per RECIST 1.1 as assessed by BICR, or death due to any cause in centrally confirmed MET IHC+ population of FAS (FAS-IHC+)., Overall survival defined as time from randomisation until the date of death due to any cause in FAS-IHC+., Progression-free survival defined as time from randomization until progression per RECIST 1.1 as assessed by investigator, or death due to any cause in centrally confirmed MET IHC+ population of FAS (FASIHC+)., A/ Objective response rate will be based on BOR defined as the proportion of participants who have BOR of a CR or PR, as determined by BICR per RECIST 1.1. B/ Duration of response defined as the time from the date of first documented response until date of documented progression per RECIST 1.1 as assessed by BICR, or death in the absence of disease progression. C/Disease control rate defined as the proportion of participants who have BOR of a CR, PR, or stable disease [...], A/ TTD in pulmonary core symptoms (dyspnoea, cough, and chest pain) as measured by the questionnaire. B/TTD is defined as the time from randomisation until the date of deterioration., Plasma concentrations of savolitinib and its metabolites in the PK Analysis Set., Safety and tolerability will be evaluated in terms of AEs, SAEs, discontinuation rate due to AEs and deaths; clinical chemistry/haematology including LFTs; ECHOs/MUGAs, ECGs, ECOG performance status and vital signs in the Safety Analysis Set., CNS PFS, defined as the time from randomisation until the date of CNS progression assessed per CNS modified RECIST v1.1 by BICR or death in the FAS population. • CNS ORR defined as the proportion of participants who have a BOR in the CNS by BICR assessment in the cFAS population. • CNS DoR defined as the time from the date of first documented response in the CNS until the date of objective CNS progression as assessed by BICR or death in the absence of disease progression in the cFAS population.

Source: https://euclinicaltrials.eu/ctis-public/view/2024-511169-12-00